EU clinical trial 2024-515053-21-00: Phase II, multicenter, open-label, prospective, non-randomized study to evaluate the safety and efficacy of ARI0002h, a CAR-T cell against BCMA, for the initial treatment of patients with primary plasma cell leukaemia
Protocol code: GEM-PLASMACAR
Sponsor: Fundacio De Recerca Clinic Barcelona-Institut D’Investigacions Biomediques August Pi I Sunyer (Laboratory/Research/Testing facility). Phase: Therapeutic exploratory (Phase II). Countries: Spain (ongoing, recruiting).
Therapeutic area(s): Diseases [C] - Neoplasms [C04]
Gender: Female, Male. Age: 18-64 years, 65+ years. Enrolment: 25.
Status: Ongoing, recruiting. Start date (EU): 2025-04-30. Decision date: 2025-03-10. Results received: No. Last updated: 2026-07-27.

Condition(s): Plasma cell leukaemia
Product: LENALIDOMIDE, FLUDARABINE, CYCLOPHOSPHAMIDE, RoActemra 20 mg/mL concentrate for solution for infusion, PARACETAMOL, Cesnicabtagene autoleucel

Primary endpoint: Primary efficacy endpoints: Overall response rate (ORR) during the first 3 months after the first infusion (at least partial response according to the International Myeloma Working Group criteria), Primary safety endpoint: Rate of patients who develop a cytokine release syndrome and/or neurological toxicity in the first 30 days after CARTBCMA administration, according to the criteria and grading defined in the international consensus document (Lee, Santomasso et al. 2019).
Endpoint(s): Duration of response calculated from the time of first disease evaluation (day +28 after infusion) for those patients who achieved at least partial response., Response rates during the first year., Complete response rate (CR) at 3, 6, and 12 months after the first infusion., Overall response rate at 6, and 12 months after the first infusion., Time to complete response., Time to best response., MRD negative rate in bone marrow by flow cytometry at 3, 6 12 and 24 months., Response rate of extramedullary disease by PET-CT at 3 and 12 months., Progression-free survival, defined as the time between administration of ARI0002h and disease progression or death. Patients who are alive and in complete remission will be censored at the time of the last follow-up., Progression-free survival at 12 months after the first administration, defined as the time elapsed between the administration of ARI0002h and disease progression or death. Patients who are alive and in complete remission will be censored at the time of the last follow-up., Overall survival (OS), defined as the time between infusion of ARI0002h and death of the patient from any cause. Living patients will be censored at the time of last follow-up., Presence of infusion reactions, understood as the appearance of any of the following symptoms after the intravenous administration of CARTBCMA: cardiac events, chills, dyspnoea, fatigue, sudden hypertension, hypotension, nausea, pain, fever, rash or urticaria., Tumour lysis syndrome at any time after treatment administration., Cytokine release syndrome. According to the criteria and grading defined in the international consensus document (Lee, Santomasso et al. 2019 )., Neurological toxicity (According to the criteria and grading defined in the international consensus document (Lee, Santomasso et al. 2019))., Presence of prolonged cytopenias, defined as a grade 4 decrease in peripheral blood neutrophil or platelet counts for more than 4 weeks after infusion., Quality of life during the first two years after infusion according to the 2009 EuroQol Group EQ-5D-5L questionnaire.

Source: https://euclinicaltrials.eu/ctis-public/view/2024-515053-21-00